EU clinical trial 2024-519933-53-00: Ventricular water absorption capacity in hydrocephalus
Protocol code: 455136
Sponsor: Oslo University Hospital HF (Hospital/Clinic/Other health care facility). Phase: Therapeutic confirmatory (Phase III). Countries: Norway (ongoing, recruiting).
Therapeutic area(s): Analytical, Diagnostic and Therapeutic Techniques and Equipment [E] - Diagnosis [E01]; Diseases [C] - Nervous System Diseases [C10]
Gender: Female, Male. Age: 18-64 years, 65+ years. Enrolment: 100.
Status: Ongoing, recruiting. Start date (EU): 2025-01-29. Decision date: 2025-01-29. Results received: No. Last updated: 2026-06-22.

Condition(s): Adult hydrocephalus

Primary endpoint: From venous blood-samples during ventricular 15-oxygen-water infusion testing establish population pharmacokinetic measures of ventricular water absorption capacity on the individual basis. These measures include time to peak concentration, maximum concentration, area under curve and half time to 50% clearance.
Endpoint(s): Image ventricular water absorption to brain using positron emission tomography (PET) imaging in communicating and non-communicating hydrocephalus., Quantify cerebral blood flow using intravenous 15-oxygen-water PET/CT., Compare water-exchange parameters obtained from intravenous and intraventricular 15-oxygen-water administration., Establish the safety and tolerability of the method, including adverse events related to the additional intravenous PET/CT procedure and arterial blood sampling.

Source: https://euclinicaltrials.eu/ctis-public/view/2024-519933-53-00